EU clinical trial 2023-503627-26-00: Phase II trial of trastuzumab deruxtecan in first-line treatment HER2-positive locally advanced or metastatic breast cancer (MBC) patients considered resistant to trastuzumab + pertuzumab + taxane due to early relapse. “TRANSCENDER Study”
Protocol code: GEICAM/2021-08
Sponsor: Grupo Espanol De Investigacion En Cancer De Mama (Patient organisation/association). Phase: Therapeutic exploratory (Phase II). Countries: Spain (ended).
Therapeutic area(s): Diseases [C] - Neoplasms [C04]
Gender: Female, Male. Age: 18-64 years, 65+ years. Enrolment: 41.
Status: Ended. Start date (EU): 2023-09-28. End date (EU): 2025-07-17. Decision date: 2023-08-18. Results received: Yes. Last updated: 2025-01-24.

Condition(s): Metastatic breast cancer
Product: DS-8201a

Primary endpoint: Objective Response Rate (ORR) is defined as the rate of complete response (CR) plus partial response (PR) based on the investigator’s assessment using the Response Evaluation Criteria in Solid Tumors (RECIST) version 1.1., out of the patients who received at least 1 dose of treatment.
Endpoint(s): Other efficacy endpoints: Progression-Free Survival (PFS) is defined as the time from the date of enrollment to the date of disease progression, based on the investigator’s assessment using RECIST version 1.1., or death from any cause, whichever occurs first., Other efficacy endpoints: Overall Survival (OS) is defined as the time from the date of enrollment to the date of death from any cause., Other efficacy endpoints: Time to treatment response (TTR) is defined as the time from the date of enrollment to the date of first documentation of objective tumor response (CR or PR)., Other efficacy endpoints: Duration of response (DoR) is defined as the time from the date of first documentation of objective tumor response (CR or PR) to the date of first documented progressive disease based on the investigator’s assessment using RECIST version 1.1., or death from any cause, whichever occurs first., Safety: Incidence and severity of Adverse Events (AEs) and clinical lab abnormalities. AEs grades will be defined by the National Cancer Institute Common Terminology Criteria for AEs (NCI-CTCAE) version 5.0. AE terms will be coded according to the MedDRA dictionary., Tolerability: Incidence of T-DXd dose modifications, discontinuations due to AEs, number of administered cycles, dose intensity, etc., Changes (mean score) and time to deterioration on EORTC QLQ-C30 Global Health Status/QoL from baseline.

Source: https://euclinicaltrials.eu/ctis-public/view/2023-503627-26-00